EU clinical trial 2023-510051-27-00: Phase I / II, open label, dose escalation part (phase I) followed by non-comparative expansion part (phase II), multi-centre study, evaluating safety, pharmacokinetics and efficacy of S65487, a Bcl2 inhibitor combined with azacitidine in adult patients with previously untreated acute myeloid leukemia not eligible for intensive treatment
Protocol code: CL1-65487-003
Sponsor: Institut De Recherches Internationales Servier IRIS (Pharmaceutical company). Phase: Phase I and Phase II (Integrated)- First administration to humans. Countries: France (ended), Spain (ended).
Therapeutic area(s): Diseases [C] - Neoplasms [C04]
Gender: Female, Male. Age: 18-64 years, 65+ years. Enrolment: 40.
Status: Ended. Start date (EU): 2021-02-25. End date (EU): 2026-03-27. End date: 2026-03-28. Decision date: 2024-06-07. Results received: No. Last updated: 2026-02-13.
Decision dates by country: ES: 2024-06-07, FR: 2024-06-12

Condition(s): Acute Myeloid Leukemia (AML)
Product: Posaconazol STADA 100 mg magensaftresistente Tabletten, S65487 Solution for infusion 100 mg, Vidaza 25 mg/ml powder for suspension for injection

Primary endpoint: Phase I: DLT assessment at the end of cycle 1, Phase I: AE recording throughout the study evaluated according to CTCAE v5.0, dose interruptions, reductions, and intensity, Phase I: Vitals signs, Laboratory tests, ECG, Phase II: CR rate: Complete Remission (CR) rate., Phase II: Antileukemic activity assessment using blood, bone marrow aspirate and bone marrow biopsies, if available, according to ELN 2022 response criteria and FDA
Endpoint(s): For phase I: PK parameters of S65487, azacitidine and potential metabolite(s) if applicable will be determined in plasma (e.g. Cinf, tinf, AUClast, tlast, Clast, AUC, t½, z, CL and Vss), For phase I: CR rate: Complete Remission (CR) rate, CR rate by initiation of cycle 2 (CR2), CR plus CRi rate: Complete Response rate with incomplete hematologic recovery, CR plus CRh rate: Complete Response with partial hematologic recovery, Duration of Response (DOR), Event Free Survival (EFS), Progression Free Survival (PFS), Overall Survival (OS), time to first response, For phase I: Antileukemic activity assessment using blood, bone marrow aspirate and medullary biopsies if available according to ELN 2022 response criteria and FDA, Phase II: CR plus CRi and CR plus CRh rate, CR by initiation of cycle 2, DOR, EFS, PFS, OS, time to first response, Minimal Residual Disease analysed centrally on pre- and on-treatment Bone marrow samples of participants at the same time as clinical response assessment. Incidence and severity of adverse events.

Source: https://euclinicaltrials.eu/ctis-public/view/2023-510051-27-00